EU clinical trial 2025-524693-42-00: A study to see how RO7763505 works and how safe it is when given to healthy people and people with stable heart disease
Protocol code: BP46355
Sponsor: F. Hoffmann-La Roche AG (Pharmaceutical company). Phase: Human Pharmacology (Phase I)- First administration to humans. Countries: Netherlands (ongoing, recruiting).
Therapeutic area(s): Diseases [C] - Cardiovascular Diseases [C14]
Gender: Female, Male. Age: 18-64 years, 65+ years. Enrolment: 196.
Status: Ongoing, recruiting. Start date (EU): 2026-03-09. Decision date: 2026-03-06. Results received: No. Last updated: 2026-04-29.

Condition(s): Stable Coronary Artery Disease (CAD)

Source: https://euclinicaltrials.eu/ctis-public/view/2025-524693-42-00